EU clinical trial 2025-523509-13-00: Phase 2, Open-Label, Long-Term, Extension (OLE) Study of Infigratinib, an FGFR 1-3-Selective Tyrosine Kinase Inhibitor, in Children with Hypochondroplasia: ACCEL OLE
Protocol code: QBGJ398-205
Sponsor: Qed Therapeutics Inc. (Pharmaceutical company). Phase: Therapeutic exploratory (Phase II). Countries: Spain (ongoing, recruiting), Norway (authorised, recruiting).
Therapeutic area(s): Diseases [C] - Congenital, Hereditary, and Neonatal Diseases and Abnormalities [C16]
Gender: Female, Male. Age: 0-17 years. Enrolment: 22.
Start date (EU): 2026-06-18. Decision date: 2026-04-15. Results received: No. Last updated: 2026-04-15.
Decision dates by country: ES: 2026-04-15, NO: 2026-04-15

Condition(s): Hypochondroplasia
Product: INFIGRATINIB, INFIGRATINIB, INFIGRATINIB, INFIGRATINIB, Infigratinib

Primary endpoint: Incidence, type, severity, and causality of AEs; SAEs; AEs that require dose reduction or discontinuation per study protocol; and changes over time in vital signs, laboratory assessments and special investigations (ophthalmic and dental evaluations), and imaging (x-rays, , dual x-ray absorptiometry [DXA] scan)., Changes over time in standing height Z-score (in relation to both HCH and average height tables for age and sex).
Endpoint(s): Changes over time in AHV and AHV Z-score in relation to average height tables for age and in body proportions including upper to lower body segment ratio, upper arm to forearm length ratio, upper leg to lower leg length ratio, arm span to standing height ratio, and head circumference to standing height ratio, in weight Z-score and BMI in relation to average height tables (and HCH tables, if and when they become available), age of puberty onset and time to X, in body composition, Change over time in various quality of life scales including Pediatric Quality of Life, Quality of Life in Short Stature Youth, Patient/ Parent Global Impression of Severity and Change, Treatment benefit as reported by parent and participant during qualitative interview., Changes over time in body composition as assessed by dual x-ray absorptiometry (DXA) scans., Changes over time in bone morphology/density by x-ray and DXA.

Source: https://euclinicaltrials.eu/ctis-public/view/2025-523509-13-00